EU clinical trial 2022-502615-11-00: A Study to Evaluate the Safety, Pharmacokinetics, and Activity of RO7496353 in Combination with a Checkpoint Inhibitor with or without Standard-of-Care Chemotherapy in Patients with Locally Advanced or Metastatic Solid Tumors
Protocol code: GO44010
Sponsor: Genentech Inc. (Pharmaceutical company). Phase: Human Pharmacology (Phase I)- First administration to humans. Countries: Italy (ended), Spain (ended).
Therapeutic area(s): Diseases [C] - Neoplasms [C04]
Gender: Female, Male. Age: 18-64 years, 65+ years. Enrolment: 35.
Status: Ended. Start date (EU): 2023-11-29. End date (EU): 2026-01-22. End date: 2026-03-16. Decision date: 2023-11-10. Results received: No. Last updated: 2026-01-21.
Decision dates by country: IT: 2023-11-14, ES: 2023-11-10

Condition(s): Locally Advanced or Metastatic Solid Tumors

Source: https://euclinicaltrials.eu/ctis-public/view/2022-502615-11-00